EU clinical trial 2023-505203-23-01: A multi-centre, single arm, open-label extension study to evaluate the long-term safety of GSK3511294 (Depemokimab) in adult and adolescent participants with severe asthma with an eosinophilic phenotype from studies 206713 or 213744
Protocol code: 212895
Sponsor: Glaxosmithkline Research & Development Limited (Pharmaceutical company). Phase: Therapeutic confirmatory (Phase III). Countries: Germany (ended), Spain (ended), Poland (ended), Hungary (ended), Czechia (ended), France (ended), Italy (ended).
Therapeutic area(s): Diseases [C] - Respiratory Tract Diseases [C08]
Gender: Female, Male. Age: 0-17 years, 18-64 years, 65+ years. Enrolment: 372.
Status: Ended. Start date (EU): 2021-07-26. End date (EU): 2025-05-19. End date: 2025-05-19. Decision date: 2024-02-14. Results received: Yes. Last updated: 2025-07-07.
Decision dates by country: PL: 2024-02-25, ES: 2024-02-15, HU: 2024-02-14, CZ: 2024-02-15, IT: 2024-02-20, DE: 2024-02-16, FR: 2024-02-15

Condition(s): Severe asthma with an eosinophilic phenotype

Primary endpoint: Incidence of adverse events (AEs)/serious adverse events (SAEs) over 52 weeks, Incidence of immunogenicity as measured by the presence of anti-drug antibody (ADA)/ neutralising antibody (Nab) to GSK3511294 over 52 weeks
Endpoint(s): Annualized rate of Clinically significant exacerbations over 52 weeks, Change from Baseline in Asthma Control Questionnaire-5 (ACQ-5) score at discrete timepoints during the 52 week period, Change from Baseline in St. George's Respiratory Questionnaire (SGRQ) total score at Week 26 and Week 52, Change from Baseline in prebronchodilator FEV1 at Week 26 and Week 52

Source: https://euclinicaltrials.eu/ctis-public/view/2023-505203-23-01